EU clinical trial 2022-501221-21-00: Randomized trial on Spinal Anaesthesia vs. General Anaesthesia (SAGA) on recovery after total hip, total knee, and unicompartmental knee arthroplasty
Sponsor: Hvidovre Hospital (Hospital/Clinic/Other health care facility). Phase: Therapeutic use (Phase IV). Countries: Denmark (ended).
Therapeutic area(s): Analytical, Diagnostic and Therapeutic Techniques and Equipment [E] - Anesthesia and Analgesia [E03]; Diseases [C] - Musculoskeletal Diseases [C05]; Analytical,Diagnostic,Therapeutic Techniques and Equipment [E]-Surgical Procedures, Operative [E04]
Gender: Female, Male. Age: 18-64 years, 65+ years. Enrolment: 222.
Status: Ended. Start date (EU): 2023-02-03. End date (EU): 2025-04-06. Decision date: 2022-11-17. Results received: Yes. Last updated: 2024-12-03.

Condition(s): Osteoarthritis of the hip and knee
Product: PROPOFOL, DEXAMETHASONE PHOSPHATE, PROPOFOL, BUPIVACAINE HYDROCHLORIDE, TRANEXAMIC ACID, PARACETAMOL, SUFENTANIL, ONDANSETRON, SODIUM LACTATE, SODIUM CHLORIDE, REMIFENTANIL, POTASSIUM CHLORIDE, CALCIUM CHLORIDE, REMIFENTANIL, REMIFENTANIL, ROPIVACAINE HYDROCHLORIDE, CELECOXIB

Primary endpoint: Whether or not the participant is able to safely and independently walk 5 meters (also when using walking aid) within 6 hours of surgery.
Endpoint(s): Fulfilment of discharge criteria, Pain score and opioid use, Postoperative nausea and vomiting (PONV), Dizziness score, Quality of Recovery (QoR-15), Opioid-Related Symptom Distress Scale (ORSDS) questionnaire, 3-minute Diagnostic Interview – Confusion Assessment Method (3D-CAM), Urinary retention, Emergency room contacts, complications, readmission or mortality within 30 days of surgery

Source: https://euclinicaltrials.eu/ctis-public/view/2022-501221-21-00